EU clinical trial 2023-507410-27-00: A Phase 2, Randomized, Double-blind, Placebo-controlled, Multi-center, Dose-ranging Study to Evaluate the Efficacy and Safety of Verekitug (UPB-101) in Adult Participants with Severe Asthma (VALIANT)
Protocol code: UPB-CP-04
Sponsor: Upstream Bio Inc. (Pharmaceutical company). Phase: Therapeutic exploratory (Phase II). Countries: Czechia (ended), Poland (ended), Italy (ended), Germany (ended), Bulgaria (ended), Spain (ended).
Therapeutic area(s): Diseases [C] - Respiratory Tract Diseases [C08]
Gender: Female, Male. Age: 18-64 years, 65+ years. Enrolment: 182.
Status: Ended. Start date (EU): 2024-06-19. End date (EU): 2026-03-02. Decision date: 2024-04-30. Results received: No. Last updated: 2025-09-29.
Decision dates by country: IT: 2024-04-30, DE: 2024-05-02, ES: 2024-04-30, BG: 2024-04-30, PL: 2024-05-02, CZ: 2024-05-02

Condition(s): Severe Asthma
Product: Verekitug (UPB-101), Veritikug (UPB-101) matching solution for subcutaneous injection with no active treatment

Primary endpoint: AAER over 60 weeks of treatment Annualized Asthma Exacerbation Rate (AAER) over 60 weeks of treatment
Endpoint(s): Change from baseline to Week 60 in pre-BD FEV1, Change from baseline to Week 60 in FeNO, Change from baseline to Week 60 in ACQ-6

Source: https://euclinicaltrials.eu/ctis-public/view/2023-507410-27-00